EU clinical trial 2022-500307-49-00: AMUM trial -Adjuvant Melatonin for Uveal Melanoma: A randomized open Phase III Study
Sponsor: St Erik Eye Hospital (Hospital/Clinic/Other health care facility). Phase: Therapeutic confirmatory (Phase III). Countries: Sweden (ongoing, recruiting).
Therapeutic area(s): Diseases [C] - Eye Diseases [C11]
Gender: Female, Male. Age: 18-64 years, 65+ years. Enrolment: 100.
Status: Ongoing, recruiting. Start date (EU): 2022-10-03. Decision date: 2022-06-22. Results received: No. Last updated: 2024-06-04.

Condition(s): uveal melanoma
Product: Melatonin AGB 5 mg tabletter

Primary endpoint: Andel forskningspersoner som är fria från metastaser 5 år efter randomisering i melatonin- respektive kontrollarm (relativ risk)
Endpoint(s): 1. Totalöverlevnad 5 år efter randomisering (Kaplan-Meier-kurvor och Log-rank test), 2. Risk att ha utvecklat annan cancer 5 år efter randomisering (Cox regression riskkvot), 3. Totalöverlevnad efter upptäckt av metastaser (Kaplan-Meier-kurvor och Log-rank test), 4. Andel forskningspersoner med AE och SAE i melatonin- och kontrollarm under perioden 0–5 år efter randomisering (relativ risk)

Source: https://euclinicaltrials.eu/ctis-public/view/2022-500307-49-00